EU clinical trial 2023-503427-26-00: A Study to Evaluate CC-486 in Participants With Moderate or Severe Hepatic Impairment Compared With Normal Hepatic Function in Cancer Participants
Protocol code: CA055-001
Sponsor: Celgene Corp. (Pharmaceutical company). Phase: Human Pharmacology (Phase I)- Other. Countries: Spain (ended), Germany (ended).
Therapeutic area(s): Diseases [C] - Hemic and Lymphatic Diseases [C15]
Gender: Female, Male. Age: 18-64 years, 65+ years. Enrolment: 14.
Status: Ended. Start date (EU): 2023-11-10. End date (EU): 2025-11-24. End date: 2025-11-25. Decision date: 2023-08-25. Results received: No. Last updated: 2025-10-07.
Decision dates by country: ES: 2023-08-25, DE: 2023-08-28

Condition(s): Myeloid malignancies with moderate or severe hepatic impairment or normal hepatic function

Source: https://euclinicaltrials.eu/ctis-public/view/2023-503427-26-00